EU clinical trial 2024-512023-37-00: A phase II, randomized, open-label study comparing salvage radiotherapy in combination with 6 months of androgen-deprivation therapy (ADT) with LHRH agonist or antagonist versus anti-androgen therapy (AAT) with apalutamide in patients with biochemical progression after radical prostatectomy
Protocol code: CTOR18001GZA
Sponsor: Ziekenhuis Aan De Stroom (Hospital/Clinic/Other health care facility). Phase: Therapeutic exploratory (Phase II). Countries: Belgium (ongoing, recruitment ended).
Therapeutic area(s): Diseases [C] - Neoplasms [C04]; Diseases [C] - Male Urogenital Diseases [C12]
Gender: Male. Age: 18-64 years, 65+ years. Enrolment: 202.
Status: Ongoing, recruitment ended. Start date (EU): 2024-06-27. Decision date: 2024-06-27. Results received: No. Last updated: 2025-09-11.

Condition(s): Prostate cancer
Product: DEPO-ELIGARD 45 mg poudre et solvant pour solution injectable, FIRMAGON 80 mg powder and solvent for solution for injection, Decapeptyl Sustained Release 11,25 mg Pulver und Lösungsmittel zur Herstellung einer Injektionssuspension, JNJ-56021927, FIRMAGON 80 mg powder and solvent for solution for injection, ZOLADEX Long Acting, 10,8 mg, implant

Primary endpoint: EPIC-26 sexual domain score at 9 months after start of hormonal treatment (0 – 100 scale, with higher scores representing better sexual function)
Endpoint(s): Quality of life will be assessed using EPIC-26 as well as the European Organisation for Research and Treatment of Cancer (EORTC) quality of life questionnaire (QLQ) C30 and PR25 as well as FACT-P, Acute as well as late toxicity will be assessed using the Common Terminology Criteria for Adverse Events (CTCAE) version 5.0 (published November 27, 2017), Regarding efficacy, prostate-specific antigen (PSA) response rates, defined as a decline from baseline in PSA level of 80% or greater, as well as PSA complete response rates, defined as a decline from baseline in PSA level of 90% or greater, will be prospectively collected at the 4 treatment visits (i.e. at 0, 3, 6, and 9 months), Metastasis-free survival, Radiation therapy quality assurance

Source: https://euclinicaltrials.eu/ctis-public/view/2024-512023-37-00